EU clinical trial 2024-518033-28-00: Multicentre, open-label, randomised, two-arm, parallel-group, superiority study to assess bioavailability and practicability of Envarsus® compared with Advagraf® in de novo liver transplant recipients
Protocol code: EnGraft
Sponsor: Universitaetsklinikum Regensburg AöR (Hospital/Clinic/Other health care facility). Phase: Therapeutic use (Phase IV). Countries: Germany (ongoing, recruitment ended).
Therapeutic area(s): Phenomena and Processes [G] - Immune system processes [G12]
Gender: Female, Male. Age: 18-64 years, 65+ years. Enrolment: 268.
Status: Ongoing, recruitment ended. Start date (EU): 2020-11-27. Decision date: 2024-10-31. Results received: No. Last updated: 2026-05-26.

Condition(s): Prophylaxis of transplant rejection in adult liver allograft recipients
Product: Advagraf 3 mg prolonged-release hard capsules, Advagraf 1 mg prolonged-release hard capsules, Envarsus 4 mg prolonged-release tablets, Advagraf 0.5 mg prolonged-release hard capsules, Advagraf 5 mg prolonged-release hard capsules, Envarsus 1 mg prolonged-release tablets, Envarsus 0.75 mg prolonged-release tablets

Primary endpoint: Dose-normalised trough level (C/D ratio) measured at 12 weeks
Endpoint(s): Number of IMP dose adjustments until 12 weeks, Time to reach the first defined range in target trough level, Number of measurements above and below the first defined range in target trough level, Dose-normalised trough level (C/D ratio) measured at 1, 2 and 3 years, Mean tacrolimus trough level and inter-patient variability (range) of tacrolimus trough levels at 1, 2, 4 and 12 weeks, Inter-patient variability (range) of tacrolimus total daily dose until 12 weeks, Proportion of patients with trough levels lower, within, or higher than the standard reference range at 1, 2, 4 and 12 weeks, Incidence and severity (BANFF criteria) of clinically-confirmed BPAR2 at 12 weeks and 1, 2, 3 years, Incidence of graft failure (defined as necessity for re-transplantation) at 12 weeks and 1, 2, 3 years, Incidence of death (for any reason) at 12 weeks and 1, 2, 3 years, Treatment failure rate (composite endpoint of BPAR, graft failure or death) at 12 weeks and 1, 2, 3 years, Time to treatment failure (composite endpoint of BPAR, graft failure3 or death) after randomisation, Incidence of acute rejections requiring treatment at 12 weeks, Incidence of multiple rejection episodes at 12 weeks, Laboratory measures at 12 weeks and 1, 2, 3 years: liver function, metabolic profile, renal function, Malignancies at 1, 2 and 3 years, Infections (HCV, HBV, CMV, EBV) at 1, 2 and 3 years, Degree of liver fibrosis (fibroscan4 or biopsy) at 12 weeks and 1, 2, 3 years, Incidence, type, severity, seriousness and causality of adverse events (AEs), Change vs. baseline in vital signs (heart rate, blood pressure) and body weight, Incidence of de novo occurrence of tremor or vision impairments, Incidence of post-transplant diabetes mellitus and post-transplant hyperglycaemia at 12 weeks and 1, 2, 3 years, Dose-normalised trough level (C/D ratio) 12 weeks after transplantation, Number and doses of immunosuppressive medications (incl. other tacrolimus formulations) at 12 weeks and after 12 weeks (if applicable), Recurrence of primary hepatic disease, Incidence of DSA up to 12 weeks and at 1, 2 and 3 years (optional), Continuation rate at 12 weeks, Incidence and time to study treatment discontinuation, Incidence, time to and reason for patient withdrawal from study

Source: https://euclinicaltrials.eu/ctis-public/view/2024-518033-28-00